EU clinical trial 2025-522766-78-00: A study investigating the safety, absorption, and elimination of RO7795081, a new compound that may potentially be used in the treatment of type 2 diabetes and weight control
Protocol code: BP46037
Sponsor: F. Hoffmann-La Roche AG (Pharmaceutical company). Phase: Human Pharmacology (Phase I)- Other. Countries: Netherlands (ended).
Therapeutic area(s): Health Care [N] - Population Characteristics [N01]
Gender: Female, Male. Age: 18-64 years. Enrolment: 16.
Status: Ended. Start date (EU): 2025-11-10. End date (EU): 2026-04-14. Decision date: 2025-11-07. Results received: No. Last updated: 2026-03-20.

Source: https://euclinicaltrials.eu/ctis-public/view/2025-522766-78-00